EU clinical trial 2023-504647-14-00: A multicenter, phase 2 randomized, open label study to evaluate the efficacy and security of zanubrutinib in combination with obinutuzumab in previously untreated patients with Chronic Lymphocytic Leukemia (CLL) or Small Lymphocytic Lymphoma (SLL) (GELLC-10-ZANUBIO)
Protocol code: GELLC-10-ZANUBIO
Sponsor: Pethema Fundacion (Patient organisation/association). Phase: Therapeutic exploratory (Phase II). Countries: Spain (ongoing, recruiting).
Therapeutic area(s): Diseases [C] - Hemic and Lymphatic Diseases [C15]
Gender: Female, Male. Age: 18-64 years, 65+ years. Enrolment: 106.
Status: Ongoing, recruiting. Start date (EU): 2024-09-02. Decision date: 2024-07-29. Results received: No. Last updated: 2026-07-14.

Condition(s): Chronic Lymphocytic Leukemia (CLL) or Small Lymphocytic Lymphoma (SLL)
Product: Zanubrutinib, Gazyvaro 1,000 mg concentrate for solution for infusion.

Primary endpoint: The primary endpoint of the study is the complete response rate (CRR) with undetectable minimal residual disease (uMRD).
Endpoint(s): Overall response rate (ORR), including partial response with lymphocytosis., Progression-free survival (PFS), defined as the time from randomization until symptomatic disease progression (as defined by the updated iwCLL-guidelines) or death by any cause, whichever occurs first., Overall survival (OS), defined as the time between the day of randomization to death from any cause., Immunological recovery, Safety: type, frequency, and severity of adverse events (AEs) and relationship of AEs to zanubrutinib or the combination of zanubrutinib and obinutuzumab, including the assessment of tumour lysis syndrome., Potential predictive biomarkers of response to zanubrutinib and obinutuzumab and mechanisms of resistance in patients diagnosed with CLL [Visits: Baseline, cycle 20, and at progression].

Source: https://euclinicaltrials.eu/ctis-public/view/2023-504647-14-00